EU clinical trial 2024-511927-32-00: A Phase 1 study to look at RP-6306 in combination with FOLFIRI as a treatment for Advanced Solid Tumours
Protocol code: RP-6306-03
Sponsor: Repare Therapeutics USA Inc. (Pharmaceutical company). Phase: Human Pharmacology (Phase I)- First administration to humans. Countries: Spain (ended).
Therapeutic area(s): Diseases [C] - Neoplasms [C04]
Gender: Female, Male. Age: 18-64 years, 65+ years. Enrolment: 26.
Status: Ended. End date (EU): 2024-09-19. End date: 2025-02-12. Decision date: 2024-04-24. Results received: No. Last updated: 2024-09-09.

Condition(s): Advanced solid tumours

Source: https://euclinicaltrials.eu/ctis-public/view/2024-511927-32-00